EU clinical trial 2023-506110-43-00: A Phase 1/2, Multicenter, Dose-Escalation and Expansion Study of Combination Therapy with Venetoclax, Daratumumab and Dexamethasone (With and Without Bortezomib) in Subjects with Relapsed or Refractory Multiple Myeloma
Protocol code: M15-654
Sponsor: AbbVie Deutschland GmbH & Co. KG (Pharmaceutical company). Phase: Phase I and Phase II (Integrated)- Other. Countries: Denmark (ongoing, recruitment ended), France (ongoing, recruitment ended), Germany (ended).
Therapeutic area(s): Diseases [C] - Neoplasms [C04]
Gender: Female, Male. Age: 18-64 years, 65+ years. Enrolment: 18.
Start date (EU): 2018-01-25. Decision date: 2024-05-24. Results received: No. Last updated: 2026-06-10.
Decision dates by country: DE: 2024-06-21, DK: 2024-05-24, FR: 2024-06-17

Condition(s): Multiple Myeloma
Product: DARZALEX 1800 mg solution for injection, DARZALEX 20 mg/mL concentrate for solution for infusion, DARZALEX 20 mg/mL concentrate for solution for infusion, DEXAMETHASONE, DARZALEX 20 mg/mL concentrate for solution for infusion, Venetoclax, VELCADE 3.5 mg powder for solution for injection

Primary endpoint: Overall response rate (ORR), Very good partial response (VGPR) or better rate, Complete response (CR) or better rate, Time to response (TTR), Duration of response (DOR), Time to progression (TTP), Progression-free survival (PFS), Overall survival (OS)
Endpoint(s): Minimal Residual Disease (MRD), Safety, Pharmacokinetic (PK) and Biomarker Research Variables

Source: https://euclinicaltrials.eu/ctis-public/view/2023-506110-43-00